EU clinical trial 2024-515063-66-00: Radiation-Free Therapy for the Initial treatment of Good prognosis early non-bulky HL, defined by a low Metabolic Tumor Volume and a negative interim PET after 2 chemotherapy cycles (RAFTING-2019)
Protocol code: NBK132/1/2020
Sponsor: Medical University Of Gdansk (Educational Institution). Phase: Therapeutic exploratory (Phase II). Countries: Spain (ongoing, recruiting), Italy (ongoing, recruiting), Poland (ongoing, recruiting).
Therapeutic area(s): Diseases [C] - Hemic and Lymphatic Diseases [C15]
Gender: Female, Male. Age: 18-64 years, 65+ years. Enrolment: 145.
Status: Ongoing, recruiting. Start date (EU): 2021-03-30. Decision date: 2024-11-22. Results received: No. Last updated: 2024-11-27.
Decision dates by country: IT: 2024-11-27, ES: 2024-11-22, PL: 2024-11-24

Condition(s): Early stage classical Hodgkin Lymphoma (cHL) without bulky lesions and constitutional symptoms
Product: NIVOLUMAB

Primary endpoint: To evaluate the overall efficacy in terms of 3-Y PFS equal or superior to 90% , defined as the time from registration until first occurrence of disease progression or relapse, or death for any reason of chemotherapy alone in non-bulky stage I-IIA Hodgkin Lymphoma (eHL), patients with a very low risk of treatment failure, as defined by both a low Metabolic Tumor Volume (MTV) and a negative interim PET after 2 ABVD cycle (PET-2).
Endpoint(s): To explore the efficacy in terms of 3-Y PFS defined as the time from registration until first occurrence of disease progression or relapse, or death for any reason of CMT plus Nivolumab in high-risk eHL, defined either by a positive PET-2 or a high baseline MTV or both., To evaluate the efficacy, in terms of three-year freedom from second treatment Failure (3-Y FF2TF), measured from the date of registration to the date of second relapse after radiotherapy “on demand” to rescue patients relapsed after CT alone with the pattern of “limited relapse” for the entire group (relapsed and non-relapsed) of low-risk patients (with low MTV and negative PET2)., To evaluate the safety, in terms of 3-Y OS, defined as the time from enrollment until death for any reason of the delayed radiotherapy (RT ,,on demand”) followe by Nivolumab maintenance in rescuing patients who relapsed after chemotherapy alone with the pattern of ,,limited relapse”., Overall accuracy, sensitivity, specificity, negative predictive value and positive predictive value of cell-free DNA to detect an impending relapse during follow-up of patients treated with chemotherapy alone

Source: https://euclinicaltrials.eu/ctis-public/view/2024-515063-66-00